EU clinical trial 2022-502023-21-00: A multicentre, single arm trial on contraceptive efficacy, safety and tolerability of LVDS (Levonorgestrel Vaginal Delivery System) during 13 cycles.
Protocol code: LR-301
Sponsor: Chemo Research S.L. (Pharmaceutical company). Phase: Therapeutic confirmatory (Phase III). Countries: Germany (ended), Hungary (ended), Czechia (ended), Poland (ended), Spain (ended), Lithuania (ended), Slovakia (ended), Romania (ended).
Therapeutic area(s): Phenomena and Processes [G] - Reproductive and Urinary Physiological Phenomena [G08]
Gender: Female. Age: 0-17 years, 18-64 years. Enrolment: 1037.
Status: Ended. Start date (EU): 2023-07-12. End date (EU): 2025-08-01. Decision date: 2023-07-12. Results received: Yes. Last updated: 2025-06-03.
Decision dates by country: RO: 2023-07-17, LT: 2023-07-14, CZ: 2023-07-12, SK: 2023-07-17, PL: 2023-07-17, DE: 2023-07-12, ES: 2023-07-12, HU: 2023-07-17

Condition(s): Prevention of pregnancy
Product: Levonorgestrel Vaginal Delivery System 75

Primary endpoint: Overall Pearl Index (PI) in non-breastfeeding women aged 18 to 35 years (at the time of trial enrolment).
Endpoint(s): [Secondary efficacy:] Overall PI in women aged ≤ 35 years and in women > 35 years (at the time of trial enrolment)., [Secondary efficacy:] PI after correction for back-up contraception and sexual activity (evaluable cycles)., [Secondary efficacy:] PI after correction for back-up contraception and sexual activity (evaluable cycles) in women aged ≤ 35 years and in women > 35 years (at the time of trial enrolment)., [Secondary efficacy:] PI for method failure., [Secondary efficacy:] PI for method failure in women aged ≤ 35 years and in women > 35 years (at the time of trial enrolment)., [Secondary efficacy:] Pregnancy ratio by life table analysis., [Secondary efficacy:] Pregnancy ratio by life table analysis in women aged ≤ 35 years and in women > 35 years (at the time of trial enrolment)., [Secondary safety and tolerability:] Adverse events (AEs)., [Secondary safety and tolerability:] Vital Signs., [Secondary safety and tolerability:] Physical examination., [Secondary safety and tolerability:] Gynaecological examination, incl. transvaginal ultrasound examination and cervical cytology., [Secondary safety and tolerability:] Mastodynia/mastalgia/dysmenorrhoea., [Secondary safety and tolerability:] Proportion of subjects with bleeding / spotting in each cycle., [Secondary safety and tolerability:] Proportion of subjects with absence of bleeding., [Secondary safety and tolerability:] Proportion of subjects with prolonged bleeding., [Secondary safety and tolerability:] Number of days per cycle and reference period with bleeding and with spotting., [Secondary safety and tolerability:] Number of bleeding / spotting episodes per reference period., [Secondary safety and tolerability:] Duration of bleeding / spotting episodes by cycle and reference period., [Secondary safety and tolerability:] Clinical laboratory parameters (haematology, biochemistry including estradiol levels, TSH and urinalysis)., [Secondary safety and tolerability:] IP acceptability., [Secondary safety and tolerability:] Quality of Life Enjoyment and Satisfaction Questionnaire - Short Form (Q-LES-Q-SF)., [Exploratory (bone mineral density assessment): For adolescents (except for Czech Republic and Germany) (15-17 years old at the time of enrolment):] Mean absolute changes in lumbar spine (L1-L4) Z-score from baseline to V6/EDV (and VBS) as measured by DXA., [Exploratory (bone mineral density assessment): For adolescents (except for Czech Republic and Germany) (15-17 years old at the time of enrolment):] Mean absolute changes in Z-scores (femoral neck, total hip and total body less head [TBLH]) from baseline to V6/EDV (and VBS)., [Exploratory (bone mineral density assessment): For adolescents (except for Czech Republic and Germany) (15-17 years old at the time of enrolment):] Mean absolute and percentage changes in lumbar spine, femoral neck, total hip and total body less head [TBLH] BMD from baseline to V6/EDV (and VBS) as measured by DXA., [Exploratory (bone mineral density assessment): For adolescents (except for Czech Republic and Germany) (15-17 years old at the time of enrolment):] Mean absolute and percentage changes in TBLH bone mineral content (BMC) from baseline to V6/EDV (and VBS) as measured by DXA., [Exploratory (bone mineral density assessment): For adolescents (except for Czech Republic and Germany) (15-17 years old at the time of enrolment):] Proportion of subjects with percentage changes in lumbar spine, femoral neck, total hip and TBLH BMD by categories (≥ 0%; < 0% to -1.5%, < -1.5% to -3%, < -3% to -5%, < -5% to -8% and < -8%) from baseline to V6/EDV (and VBS)., [Exploratory (bone mineral density assessment): For adolescents (except for Czech Republic and Germany) (15-17 years old at the time of enrolment):] Proportion of subjects with absolute changes in Z-scores (lumbar spine, femoral neck, total hip and TBLH) by categories (≥ 0.5, < 0.5 to 0.3, < 0.3 to 0, < 0 to 0.3, < -0.3 to -0.5 and < -0.5) from baseline to V6/EDV (and VBS).

Source: https://euclinicaltrials.eu/ctis-public/view/2022-502023-21-00